EU clinical trial 2025-524955-30-01: Self-Assessment Method for Statin side-effects Or Nocebo 2
Sponsor: Copenhagen University Hospital, Region Hovedstaden (Hospital/Clinic/Other health care facility). Phase: Phase III and phase IV (Integrated). Countries: Denmark (authorised, recruitment pending).
Therapeutic area(s): Diseases [C] - Musculoskeletal Diseases [C05]; Diseases [C] - Cardiovascular Diseases [C14]
Gender: Female, Male. Age: 18-64 years, 65+ years. Enrolment: 160.
Status: Authorised, recruitment pending. Decision date: 2026-06-28. Results received: No. Last updated: 2026-06-28.

Condition(s): Cardiovascular diseases
Product: ROSUVASTATIN, The placebo product does not contain active substance and is otherwise identical to the IMP.

Primary endpoint: Proportion of patients taking rosuvastatin 20mg daily at 6 months
Endpoint(s): • To compare the proportion of patients who continue any statin treatment six months after participating in a 36-week N-of-1 trial versus standard of care (statin titration) in patients with previously reported statin intolerance.

Source: https://euclinicaltrials.eu/ctis-public/view/2025-524955-30-01